EU clinical trial 2024-511714-20-00: KRd consolidation in myeloma patients with a positive PET-CT after standard first line treatment. A phase II study
Protocol code: NMSG25/16
Sponsor: Oslo University Hospital HF (Hospital/Clinic/Other health care facility). Phase: Therapeutic exploratory (Phase II). Countries: Denmark (ended), Norway (ended).
Therapeutic area(s): Diseases [C] - Immune System Diseases [C20]; Diseases [C] - Neoplasms [C04]
Gender: Female, Male. Age: 18-64 years, 65+ years. Enrolment: 46.
Status: Ended. Start date (EU): 2018-01-30. End date (EU): 2025-05-20. Decision date: 2024-10-04. Results received: Yes. Last updated: 2025-03-26.
Decision dates by country: NO: 2024-10-04, DK: 2024-10-23

Condition(s): Multiple Myeloma
Product: LENALIDOMIDE, Kyprolis 60 mg powder for solution for infusion, DEXAMETHASONE

Primary endpoint: Proportion of PET-CT positivity after standard first line therapy, Change from PET-CT positivity to PET-CT negativity after 4 cycles of KRd consolidation.
Endpoint(s): MRD negativity by 8-colour EuroFlow after 4 cycles of KRD consolidation., Safety, Overall response rate, Progression-free survival (PFS), Time to next treatment (TTNT), Overall survival (OS), Quality of life during and after KRD consolidation

Source: https://euclinicaltrials.eu/ctis-public/view/2024-511714-20-00